EU clinical trial 2024-515447-36-00: A Phase 3, Single-Arm, Open-label, Pivotal Study to Evaluate the Efficacy and Safety of Ersodetug Compared to Baseline in Patients with Inadequately Controlled Hypoglycemia Due to Tumor-Associated Hyperinsulinism (Tumor HI)
Protocol code: RZ358-302
Sponsor: Rezolute Inc. (Pharmaceutical company). Phase: Therapeutic confirmatory (Phase III). Countries: France (authorised, recruiting), Netherlands (ongoing, recruiting).
Therapeutic area(s): Diseases [C] - Nutritional and Metabolic Diseases [C18]
Gender: Female, Male. Age: 18-64 years, 65+ years. Enrolment: 12.
Start date (EU): 2026-03-10. Decision date: 2025-07-21. Results received: No. Last updated: 2026-07-29.
Decision dates by country: FR: 2025-07-21, NL: 2025-07-22

Condition(s): Tumor-associated hyperinsulinism

Primary endpoint: Proportion of participants with clinically meaningful reduction in glucose infusion rate from baseline., OLE: Long-term glycemic efficacy (by SMBG) of ersodetug will be assessed similar to secondary endpoints of the Pivotal Treatment Period (PTP) including SOC antihypoglycemic therapies, HRQoL, OLE: Long-term safety and tolerability based on assessments of TEAEs, SAEs, Adverse Events of Special Interest (AESIs), clinical laboratory measurements, immunogenicity assessments, ECG, hepatic ultrasound, vital signs, and physical examination
Endpoint(s): Change from baseline in average daily IV glucose/dextrose infusion rate (GIR), Time to complete weaning off IV glucose administration after initiating ersodetug., Change from baseline in average daily total IV glucose delivery (g).

Source: https://euclinicaltrials.eu/ctis-public/view/2024-515447-36-00